EU clinical trial 2024-518899-31-00: CLEOPATTRA: Effects of NNC6019-0001 versus placebo on cardiovascular outcomes in participants with transthyretin amyloid cardiomyopathy (ATTR-CM).
Protocol code: NN6019-4958
Sponsor: Novo Nordisk A/S (Pharmaceutical company). Phase: Therapeutic confirmatory (Phase III). Countries: Germany (ongoing, recruiting), France (ongoing, recruiting), Belgium (authorised, recruitment pending), Italy (ongoing, recruiting), Denmark (ongoing, recruiting), Netherlands (ongoing, recruiting), Spain (ongoing, recruiting), Czechia (ongoing, recruiting).
Therapeutic area(s): Diseases [C] - Cardiovascular Diseases [C14]
Gender: Female, Male. Age: 18-64 years, 65+ years. Enrolment: 545.
Start date (EU): 2025-12-19. Decision date: 2025-12-09. Results received: No. Last updated: 2026-07-31.
Decision dates by country: BE: 2025-12-09, FR: 2025-12-11, NL: 2026-02-02, CZ: 2025-12-09, IT: 2025-12-12, DE: 2025-12-12, DK: 2025-12-09, ES: 2025-12-10

Condition(s): Variant or wild-type transthyretin (TTR) amyloid cardiomyopathy
Product: coramitug C 10035, liquid dosage form in 20 mL vials with 11 extractable volume

Primary endpoint: Number of occurrences of the composite endpoint consisting of: • CV death • Recurrent CV events (CV hospitalisation and urgent HF visits )
Endpoint(s): Secondary Confirmatory: Change in KCCQ-CSS, Change in 6MWD, Number of occurrences of CV events (CV hospitalisation and urgent HF visits), Time to occurrence of CV death, Time to occurrence of all-cause death, Time to first occurrence of composite CKD endpoint: • CV death • Onset of persistent decline eGFR ≥ 30% • Onset of persistent eGFR < 15 mL/min/1.73m2 • Initiation of chronic kidney replacement therapy (dialysis or kidney transplant), Change in KCCQ-OSS

Source: https://euclinicaltrials.eu/ctis-public/view/2024-518899-31-00